EU clinical trial 2025-523577-42-00: Open label study to investigate patch adhesion of an Esflurbiprofen-containing patch in healthy volunteers
Protocol code: TK-254RX-0107
Sponsor: Teikoku Seiyaku Co. Ltd. (Pharmaceutical company). Phase: Human Pharmacology (Phase I)- Other. Countries: Germany (ended).
Therapeutic area(s): Diseases [C] - Musculoskeletal Diseases [C05]
Gender: Female, Male. Age: 18-64 years. Enrolment: 90.
Status: Ended. Start date (EU): 2026-01-06. End date (EU): 2026-03-12. Decision date: 2025-11-13. Results received: No. Last updated: 2025-12-15.

Condition(s): Patch adhesion trial with healthy subjects, therapeutical indication not studied

Source: https://euclinicaltrials.eu/ctis-public/view/2025-523577-42-00